EU clinical trial 2024-512760-64-00: A First-In-Human (FIH) phase I/II open-label, multicenter, dose escalation and expansion trial of VERT-002 in patients with locally advanced or metastatic solid tumors including non-small cell lung cancer (NSCLC) harboring MET alterations
Protocol code: F60089IV101
Sponsor: Pierre Fabre Medicament (Pharmaceutical company). Phase: Phase I and Phase II (Integrated)- First administration to humans. Countries: Netherlands (ongoing, recruiting), Belgium (ongoing, recruiting), Germany (ongoing, recruiting), Italy (ongoing, recruiting), Spain (ongoing, recruiting), France (ongoing, recruiting).
Therapeutic area(s): Diseases [C] - Neoplasms [C04]
Gender: Female, Male. Age: 18-64 years, 65+ years. Enrolment: 154.
Status: Ongoing, recruiting. Start date (EU): 2025-02-26. Decision date: 2024-12-17. Results received: No. Last updated: 2026-07-17.
Decision dates by country: IT: 2024-12-20, NL: 2024-12-18, ES: 2024-12-20, DE: 2024-12-19, BE: 2024-12-17, FR: 2025-01-21

Condition(s): locally advanced or metastatic solid tumors with MET alterations
Product: VERT-002

Primary endpoint: Part 1: Safety: Incidence and severity of Treatment Emergent Adverse Events (TEAEs)/Treatment Emergent Serious Adverse Events (TESAEs) including changes in laboratory values, physical examination, Eastern Cooperative Oncology Group (ECOG) performance status, vital signs and electrocardiogram (ECG) according to National Cancer Institute (NCI) Common Terminology Criteria for Adverse Events (CTCAE) v5.0 criteria (NCI 2017)., Part 1: Tolerability: TEAEs/TESAEs leading to VERT-002 dose reductions, interruptions, and discontinuations., Part 1: OBD: Pharmacokinetics (PK) exposures, pharmacodynamics, Objective Response Rate (ORR). Type, incidence, and severity of TEAEs/TESAEs according to NCI CTCAE 5.0 criteria (NCI 2017)., Part 1: MTD: Number and proportion of participants with locally advanced or metastatic solid tumors (including NSCLC) who experienced at least 1 Dose Limiting Toxicity (DLT) during cycle 1 i.e. the first 28 days of treatment per dose level., Part 2: ORR and cORR, PK exposures, PDs., Part 2: Overall safety, PK exposures, PDs and cORR., Part 2: Safety: Incidence and severity of TEAEs/TESAEs including changes in laboratory values, physical examination, ECOG, performance status, vital signs and ECG according to NCI-CTCAE v5.0 criteria., Part 2: Tolerability: TEAEs/TESAEs leading to VERT-002 dose reductions, interruptions, and discontinuations.
Endpoint(s): Part 1: Serum concentrations at selected time points and PK exposure parameters (e.g. Cmax, Tmax, AUC0-tau, AUC0-t, AUC0-∞, t½, kel, CL, Vss, Vd, Rac for Cmax and AUC, and Cthrough)., Part 1: Incidence, time-course, and titers of VERT-002 anti-drug antibodies (ADA) during the trial relative to prevalence of ADA signal at baseline., Part 1: Analysis of relationship between ADA incidence and safety, PK, or selected pharmacodynamic (PDs) endpoints., Part 1: Confirmed Objective Response Rate (cORR) defined as the percentage of participants with confirmed partial response (PR) or confirmed complete response (CR) based on Response Evaluation Criteria In Solid Tumors (RECIST) version 1.1. per Investigator’s Review (IR)., Part 1: Disease control rate (DCR) based on RECIST v1.1 per IR, measured as percentage of participants with CR + PR + stable disease (SD) ≥ 16 weeks., Part 1: Time To Response (TTR) according to RECIST v1.1 per IR., Part 1: Duration Of Response (DOR) according to RECIST v1.1 per IR., Part 2: DCR,TTR, DOR, Progression Free Survival (PFS) according to RECIST v1.1 per IR., Part 2: Overall Survival (OS), Part 2: Serum concentrations at selected time points and PK exposure parameters (e.g. Cmax, Tmax, AUC0-tau, AUC0-t, AUC0-∞, t½, kel, CL, Vss, Vd, Rac for Cmax and AUC, and Cthrough)., Part 2: Incidence, time-course, and titers of VERT-002 ADA during the trial relative to prevalence of ADA signal at baseline., Part 2: Analysis of relationship between ADA incidence and safety, efficacy, PK, or selected PDs endpoints.

Source: https://euclinicaltrials.eu/ctis-public/view/2024-512760-64-00